EU clinical trial 2024-518475-58-00: Impact of Albumin on Renal function in critically ill patients with Septic Shock and a high risk of Acute Kidney Injury. A Randomized Controlled Trial.
Protocol code: ALBUMIR-AKI
Sponsor: Fundacio Parc Tauli (Patient organisation/association). Phase: Therapeutic use (Phase IV). Countries: Spain (authorised, recruiting).
Therapeutic area(s): Diseases [C] - Pathological Conditions, Signs and Symptoms [C23]; Diseases [C] - Bacterial Infections and Mycoses [C01]
Gender: Female, Male. Age: 18-64 years, 65+ years. Enrolment: 100.
Status: Authorised, recruiting. Start date (EU): 2025-05-15. Decision date: 2025-02-03. Results received: No. Last updated: 2025-02-03.

Condition(s): Septic shock, acute kidney injury
Product: Albutein 200 g/l solución para perfusión.

Primary endpoint: The primary outcome will be the incidence of AKI, KDIGO stage 2-3 according to KDIGO guidelines during the first 7 days since septic shock onset
Endpoint(s): Incidence of 28-day mortality, Organ support status at day 28 measured as: length (hours) of vasopressors use; length (days) of invasive mechanical ventilation use; ventilation free days at 28 days; need of renal replacement therapy; and organ support free days at 28 days, Levels of: endothelial biomarkers Angiopoietin 1, Angiopoietin 2, MR-ProADM, Selectin, VCAM-1, ICAM-1, Endothelin-1, Thrombomodulin, Syndecan 1-4, Heparan sulfate, VEGF, S1P, and PAI-1, Proportion of participants with any AEs and SAEs related to albumin treatment, and also SUSARs

Source: https://euclinicaltrials.eu/ctis-public/view/2024-518475-58-00